EU clinical trial 2024-512613-40-00: Single-arm open-label phase I/II study in children and adolescents of 177Lu-DOTATATE (Lutathera®) combined with the PARP inhibitor olaparib for treatment of recurrent or relapsed solid tumours expressing somatostatin receptor (SSTR) (LuPARPed).
Protocol code: LuPARPed-HM-2024
Sponsor: Fundacion De investigacion De Hm Hospitales (Hospital/Clinic/Other health care facility). Phase: Phase I and Phase II (Integrated)- Other. Countries: Spain (ongoing, recruiting).
Therapeutic area(s): Not possible to specify
Gender: Female, Male. Age: 0-17 years. Enrolment: 27.
Status: Ongoing, recruiting. Start date (EU): 2024-08-28. Decision date: 2024-08-02. Results received: No. Last updated: 2026-02-23.

Condition(s): Recurrent or relapsed solid tumours expressing somatostatin receptors
Product: Lutathera 370 MBq/mL solution for infusion, Lynparza 150 mg film-coated tablets

Primary endpoint: Primary endpoint of this study is objective tumour response. Tumour response is defined by RECIST v1.122 as complete response, partial response, stable response and progressive disease (for further details refer to the Appendix E or the publication22).

Source: https://euclinicaltrials.eu/ctis-public/view/2024-512613-40-00